EU clinical trial 2024-513869-39-00: A Randomized, Double-blind, Placebo-controlled, Parallel-group, Multicenter Study to Evaluate the Efficacy and Safety of SOtaglifloziN in symptomATic obstructive And non-obstructive Hypertrophic CardioMyopathy (SONATA-HCM)
Protocol code: LX4211.1-314-HCM
Sponsor: Lexicon Pharmaceuticals Inc. (Pharmaceutical company). Phase: Therapeutic confirmatory (Phase III). Countries: Italy (ongoing, recruiting), Romania (ongoing, recruiting), France (ongoing, recruiting), Belgium (ongoing, recruiting), Sweden (ongoing, recruiting), Portugal (ongoing, recruiting), Poland (ongoing, recruiting), Spain (ongoing, recruiting), Germany (ongoing, recruiting), Croatia (ongoing, recruiting), Bulgaria (ongoing, recruiting), Hungary (ongoing, recruiting), Czechia (ongoing, recruiting).
Therapeutic area(s): Diseases [C] - Cardiovascular Diseases [C14]
Gender: Female, Male. Age: 18-64 years, 65+ years. Enrolment: 271.
Status: Ongoing, recruiting. Start date (EU): 2025-06-27. Decision date: 2025-01-15. Results received: No. Last updated: 2026-07-10.
Decision dates by country: CZ: 2025-01-16, HR: 2025-01-21, BE: 2025-01-16, DE: 2025-01-20, IT: 2025-01-20, BG: 2025-01-21, PT: 2025-01-20, FR: 2025-01-16, SE: 2025-01-17, HU: 2025-01-17, ES: 2025-01-15, PL: 2025-01-21, RO: 2025-01-21

Condition(s): Obstructive Cardiomyopathy, Hypertrophic, Non-obstructive Hypertrophic Cardiomyopathy
Product: SOTAGLIFLOZIN, PLACEBO SOTAGLIFLOZIN

Primary endpoint: Change from Baseline to Week 26 in Kansas City Cardiomyopathy Questionnaire (KCCQ) Clinical Summary Score (CSS).
Endpoint(s): Proportion of patients at Week 26 with a New York Heart Association (NYHA) functional class improvement ≥ 1 category, Change from Baseline to Week 26 in KCCQ Total Symptom Score (TSS), Treatment-emergent adverse events (TEAEs) reported during the double-blind treatment period and through Week 30., Clinical laboratory results (including serum creatinine and estimated glomerular filtration rate [eGFR]) and vital signs through Week 26., Change from Baseline at Week 4 and Week 26 in left ventricular outflow tract (LVOT) gradient (at rest and with Valsalva maneuver) as measured by echocardiogram.

Source: https://euclinicaltrials.eu/ctis-public/view/2024-513869-39-00